EU clinical trial 2025-523960-19-00: An Open-Label, Randomized, Multicenter Phase 3 Study Investigating the Efficacy and Safety of BGB-43395 Plus Letrozole versus CDK4/6 Inhibitors (Abemaciclib, Palbociclib, Ribociclib) Plus Letrozole in Patients with Advanced or Metastatic HR+/HER2- Breast Cancer Who Have Not Received Prior Systemic Anticancer Treatment for Advanced or Metastatic Disease
Protocol code: BGB-43395-302
Sponsor: BeOne Medicines I GmbH (Pharmaceutical company). Phase: Therapeutic confirmatory (Phase III). Countries: Italy (authorised, recruitment pending), Germany (authorised, recruitment pending), France (authorised, recruitment pending), Spain (authorised, recruitment pending).
Therapeutic area(s): Diseases [C] - Neoplasms [C04]
Gender: Female, Male. Age: 18-64 years, 65+ years. Enrolment: 183.
Status: Authorised, recruitment pending. Decision date: 2026-07-27. Results received: No. Last updated: 2026-08-05.
Decision dates by country: FR: 2026-07-31, DE: 2026-07-27, IT: 2026-08-05, ES: 2026-07-27

Condition(s): Advanced or Metastatic HR+/HER2- Breast Cancer
Product: LETROZOLE, PALBOCICLIB, RIBOCICLIB, BGB-43395, ABEMACICLIB, BGB-43395, ABEMACICLIB, BGB-43395, PALBOCICLIB, PALBOCICLIB, ABEMACICLIB

Primary endpoint: PFS as determined by Blinded Independent Central Review (BICR) per RECIST v1.1 and defined as the time from the date of randomization to the date of the first documentation of disease progression or death, whichever occurs first.
Endpoint(s): OS, defined as the time from the date of randomization until the date of death due to any cause., Overall response rate (ORR) determined by BICR per RECIST v1.1 and defined as the proportion of patients who had complete response (CR) or partial response (PR)., Duration of response (DOR) determined by BICR per RECIST v1.1 and defined as the time from the first occurrence of a documented objective response to the time of disease progression or death from any cause, whichever occurs first., Investigator-determined PFS as determined by investigator per RECIST v1.1 and defined as the time from the date of randomization to the date of the first documentation of disease progression or death, whichever occurs first., Clinical benefit rate (CBR) defined as the percentage of patients who have a CR, PR, or stable disease per RECIST v1.1 (without subsequent anticancer treatment) maintained for ≥ 24 weeks after randomization., Time to response (TTR) defined as the time from treatment initiation to the first response confirmed by BICR per RECIST v1.1., Progression free survival 2 (PFS2) defined as the time from randomization until progression on the next line of treatment (ie, first subsequent therapy), as assessed by the investigator, or death due to any cause, whichever occurs first., The incidence and severity of AEs according to National Cancer Institute Common Terminology Criteria for Adverse Events Version 5.0., Changes from baseline in Global Health Status/Quality of Life (GHS/QoL), physical functioning, role functioning, nausea/vomiting and diarrhea, breast symptoms, arm symptoms, and systematic therapy side effects as measured by European Organisation for Research and Treatment of Cancer (EORTC)-IL454.

Source: https://euclinicaltrials.eu/ctis-public/view/2025-523960-19-00